EU clinical trial 2024-511489-35-00: Study of safety and preliminary efficacy of VAY736 given alone or in combination with other antineoplastic agents in patients with NHL
Protocol code: CVAY736J12101
Sponsor: Novartis Pharma AG (Pharmaceutical company). Phase: Human Pharmacology (Phase I)- Other. Countries: Germany (ended), Italy (ended), Spain (ended).
Therapeutic area(s): Diseases [C] - Neoplasms [C04]
Gender: Female, Male. Age: 18-64 years, 65+ years. Enrolment: 30.
Status: Ended. Start date (EU): 2022-01-24. End date (EU): 2024-10-02. End date: 2025-02-24. Decision date: 2024-07-02. Results received: No. Last updated: 2024-07-08.
Decision dates by country: DE: 2024-07-03, IT: 2024-07-08, ES: 2024-07-02

Condition(s): Relapsed/refractory Non Hodgkin Lymphoma

Source: https://euclinicaltrials.eu/ctis-public/view/2024-511489-35-00